EU clinical trial 2023-507582-25-00: Multicentre prospective trial for extracranial malignant germ cell tumours including a randomized comparison of Carboplatin and Cisplatin (MAKEI V)
Protocol code: PAED-201601
Sponsor: Rheinische Friedrich-Wilhelms-Universitaet Bonn (Educational Institution). Phase: Therapeutic confirmatory (Phase III). Countries: Germany (ongoing, recruitment ended), Austria (ongoing, recruitment ended), Netherlands (ongoing, recruitment ended).
Therapeutic area(s): Diseases [C] - Neoplasms [C04]
Gender: Female, Male. Age: 0-17 years, 18-64 years. Enrolment: 350.
Status: Ongoing, recruitment ended. Start date (EU): 2019-08-02. Decision date: 2024-10-15. Results received: No. Last updated: 2026-07-17.
Decision dates by country: NL: 2024-10-27, AT: 2024-10-15, DE: 2024-10-15

Condition(s): Malignant Extracranial Germ Cell Tumours (MGCT)
Product: IFOSFAMIDE, ETOPOSIDE, CARBOPLATIN, CISPLATIN

Primary endpoint: Event-free survival, defined as minimum time from the date of randomization to the following events (EFSr): • Death from any cause • Progressive disease, defined as increase of standard tumour marker with or without expansion of tumour mass/metastases • Viable tumour cells at time of final surgery • Relapse • Second malignancy • or the date of the last follow-up This relates to patients randomized to Carboplatin or Cisplatin.
Endpoint(s): Event-free survival (EFS), defined as minimum time from the date of diagnosis to any of the events described above or to last follow-up, of all patients included in MAKEI V in respect to the defined MAKEI V risk groups, Overall survival (OS), defined as minimum time from the date of diagnosis to death of any cause or to last follow-up, of all patients included in MAKEI V in respect to the defined MAKEI V risk groups, Health economic parameter, e.g. hospitalization days during treatment, number of blood transfusions, in respect to treatment with Carboplatin or Cisplatin, Short and late toxicities according to CTCAE v5.0, Assessment of safety: Adverse events and laboratory abnormalitie, CTCAE v5.0 grade, timing, seriousness and relatedness., Fertility relevant endocrine outcomes, e.g. Estrogen, AMH, LH, FSH, Inhibin B., Patient reported outcomes including HRQoL, fatigue, sexual function and fertility outcomes (in adult patients), Determination of risk for relapse in respect to used surgical intervention, Radiological response rate after two (and if applicable four) cycles of either Carboplatin or Cisplatin chemotherapy, Standard tumour marker levels after every cycle of either Carboplatin or Cisplatin chemotherapy

Source: https://euclinicaltrials.eu/ctis-public/view/2023-507582-25-00